EU clinical trial 2024-512011-45-00: Open label, multicenter dose-escalation and cohort-expansion phase I/IIA trial of STC-1010, an immunotherapy, in patients with unresectable locally advanced or metastatic colorectal cancer (CRC) - BreAK CRC trial (BreAK for Brenus Anti-cancer).
Protocol code: BreAK CRC 001
Sponsor: Brenus Pharma (Pharmaceutical company). Phase: Phase I and Phase II (Integrated)- First administration to humans. Countries: France (ongoing, recruiting), Belgium (authorised, recruitment pending).
Therapeutic area(s): Diseases [C] - Digestive System Diseases [C06]; Diseases [C] - Neoplasms [C04]
Gender: Female, Male. Age: 18-64 years, 65+ years. Enrolment: 79.
Start date (EU): 2025-06-17. Decision date: 2025-01-13. Results received: No. Last updated: 2026-06-08.
Decision dates by country: FR: 2025-01-13, BE: 2025-10-06

Condition(s): Unresectable locally advanced or metastatic colorectal cancer
Product: FLUOROURACIL, ENDOXAN 50 mg, comprimé enrobé, OXALIPLATIN, Leukine, STC-1010, CALCIUM FOLINATE

Primary endpoint: Primary end point for the Phase I: Incidence, severity, and relationship of Treatment Emergent Adverse Events (TEAEs), Serious Adverse Events (SAEs), Dose-Limiting Toxicities (DLT) (in dose escalation part), AEs leading to treatment discontinuation; and clinically significant findings on clinical laboratory tests, vital signs, ECGs, and physical examinations, using the Common Terminology Criteria for Adverse Events (CTCAE Version 5)., Primary endpoint for the Phase IIa: PFS rate at 12 months from STC-1010 IS treatment initiation, defined as the proportion of participants alive and without progression (i.e., participants with CR, PR or SD) at 12 months according to RECIST 1.1

Source: https://euclinicaltrials.eu/ctis-public/view/2024-512011-45-00